EU clinical trial 2024-510697-24-00: Immunogenicity and safety of a fractional subcutaneous booster booster vaccination against mpox with MVA-BN: a randomised-controlled non-inferiority study (SUBO-trial)
Sponsor: Academisch Ziekenhuis Leiden (Hospital/Clinic/Other health care facility). Phase: Phase II and Phase III (Integrated). Countries: Netherlands (ongoing, recruiting).
Therapeutic area(s): Diseases [C] - Virus Diseases [C02]
Gender: Female, Male. Age: 18-64 years, 65+ years. Enrolment: 220.
Status: Ongoing, recruiting. Start date (EU): 2025-01-02. Decision date: 2024-12-11. Results received: No. Last updated: 2026-03-06.

Condition(s): mpox (earlier: monkey pox)
Product: IMVANEX suspension for injection Smallpox and monkeypox vaccine (Live Modified Vaccinia Virus Ankara), IMVANEX

Primary endpoint: Geometric mean concentrations (GMC) of VACV-specific antibodies (D0, D14)
Endpoint(s): GMC of antibodies against VACV (M6), MVA-BN and MPXV (D0, D14 and M6), Seroconversion for neutralizing antibodies in a subgroup of participants to VACV, MVA-BN, and MPXV (D0, D14, M6), GMT for neutralizing antibodies in a subgroup of participants to VACV, MVA-BN, and MPXV (D0, D14, M6), Percentages of MPXV- and VACV-specific T cells in a subgroup of participants, Number of spot forming unit per million cells (IFN-g ELISpot) upon stimulation with peptide gen-erated using VACV sequences, Percentages of activated T cells following peptide stimulation, Self-reported local and systemic reactions over a 7-day period, or until symptom remission, using an (electronical) diary and control visits at day 14 and month 6 months after booster vaccination, Adverse events (AEs) until one week after vaccination or until symptom remission, using an (electronical) diary and control visits at day 14 and month 6 months after booster vaccination, Serious AEs (SAEs) until six months after vaccination

Source: https://euclinicaltrials.eu/ctis-public/view/2024-510697-24-00